EU clinical trial 2024-518668-11-01: Safety and efficacy of plasma transfusion from exercise-trained donors in patients with early Alzheimer’s disease: the ExPlas Study
Protocol code: ExPlas
Sponsor: Norwegian University Of Science And Technolology (Educational Institution). Phase: Therapeutic exploratory (Phase II). Countries: Norway (ongoing, recruitment ended).
Therapeutic area(s): Diseases [C] - Nervous System Diseases [C10]
Gender: Female, Male. Age: 18-64 years, 65+ years. Enrolment: 60.
Status: Ongoing, recruitment ended. Start date (EU): 2021-09-17. Decision date: 2025-01-21. Results received: No. Last updated: 2026-04-22.

Condition(s): Early symptomatic phase Alzheimer's disease
Product: SALINE, OTHER PLASMA PROTEIN FRACTIONS, Octaplasma 45-70 mg/ml pulver og væske til infusjonsvæske, oppløsning, Saline (NaCl)

Primary endpoint: Proportion of patients with adverse events after 1 year as a measure of safety and tolerability, and number of subjects who comply with the research protocol as a measure of feasibility.
Endpoint(s): Change in performance in the CERAD 10 word Test Change in the Mini-Mental State Examination (MMSE) score Change in performance in Trail-Making test A and B Change in scores in other cognitive tests: the Clock Drawing Test, Controlled Oral Word Association Test (COWAT)-FAS, Visual Object and Space Perception (VOSP) Silhouettes Change in Clinical Dementia Rating Scale Global score

Source: https://euclinicaltrials.eu/ctis-public/view/2024-518668-11-01